EU clinical trial 2023-508485-15-00: A Phase 3 prospective, blinded, randomized, placebo controlled, international multicenter study to assess the safety and efficacy of a single subcutaneous injection of zalunfiban in subjects with ST-elevation myocardial infarction in the pre-hospital setting
Protocol code: CEL-03
Sponsor: Celecor Therapeutics Inc. (Pharmaceutical company). Phase: Therapeutic confirmatory (Phase III). Countries: Netherlands (ended), Romania (ended), Czechia (ended), France (ended), Hungary (ended).
Therapeutic area(s): Diseases [C] - Cardiovascular Diseases [C14]
Gender: Female, Male. Age: 18-64 years, 65+ years. Enrolment: 2507.
Status: Ended. Start date (EU): 2021-04-22. End date (EU): 2026-05-18. End date: 2026-05-19. Decision date: 2023-12-19. Results received: No. Last updated: 2026-08-05.
Decision dates by country: CZ: 2023-12-20, RO: 2024-01-08, HU: 2023-12-20, NL: 2023-12-19, FR: 2024-01-10

Condition(s): Subjects with documented STEMI, presenting with persistent ischemic chest pain (>10 minutes) and new ≥2 mm ST-segment elevation in 2 adjacent ECG leads, in whom the total duration of symptoms to diagnostic ECG is anticipated to be within 4 hours.
Product: Zalunfiban, Placebo for Zalunfiban

Primary endpoint: Efficacy: Clinical outcome as assessed on a 7-point scale; ranked from worst to best: 7. Death (all cause) within 30 days of randomization, 6. Stroke within 30 days of randomization, 5. Recurrent MI (yypes 1 to 4 MI) within 30 days of randomization, 4. Acute stent thrombosis within 24 hours post-PCI/angiography, 3. New onset HF or re-hospitalization for HF within 30 days of randomization, 2. MI with hs-cTnT levels ≥30 × ULN within 24 hours +/- 12 hours post study drug admin, 1. None of the above, Saferty: Subject incidence of bleeding events (according to GUSTO severe or life-threatening criterion for safety assessment and, for information only, according to the BARC Types 3C and 5 criteria) at 30-day follow-up
Endpoint(s): Efficacy: To assess after a single subcutaneous injection of zalunfiban versus placebo: As assessed by an independent Core Laboratory: Corrected TIMI Frame Count of the Infarct-Related Artery (Culprit) before PCI/angiography, Efficacy: To assess after a single subcutaneous injection of zalunfiban versus placebo: As assessed by an independent Core Laboratory: ST-segment deviation resolution 1-hour post-PCI/angiography, Efficacy: To assess after a single subcutaneous injection of zalunfiban versus placebo: Blinded bail-out use of IV αIIbβ3 receptor antagonists or IV P2Y12 antagonists at 24 hours post-PCI/angiography, Safety: To assess after a single subcutaneous injection of zalunfiban versus placebo: Recording of AEs and SAEs. AEs up to 30-day follow-up; SAEs up to resolution/stabilization, the SAEs mortality, hospitalization for HF and atrial fibrillation up to 12-month follow-up, Safety: To assess after a single subcutaneous injection of zalunfiban versus placebo: Platelet count before PCI/angiography, at the end of the PCI/angiography, 6 and 24 hours post-PCI/angiography and at hospital discharge/72-hours post-PCI/angiography (whichever occurs first), Safety: To assess after a single subcutaneous injection of zalunfiban versus placebo: Subject incidence of bleeding events (according to ISTH Major and, for information only, TIMI Major) at 30-day follow-up, Safety: To assess after a single subcutaneous injection of zalunfiban versus placebo: Subject incidence of bleeding events according to GUSTO mild and moderate criteria, BARC Types 2, 3, and 5 criteria, ISTH minor and or major bleeding, TIMI minor and major criteria at 30-day follow-up, Safety: To assess after a single subcutaneous injection of zalunfiban versus placebo: Subject incidence of injection site reactions at baseline, 1-hour post-PCI/angiography, hospital discharge/72-hours post-PCI/angiography, and at 30-day follow-up

Source: https://euclinicaltrials.eu/ctis-public/view/2023-508485-15-00